EU clinical trial 2025-522462-73-00: ILHEP : Effect of perioperative Intravenous Lidocaine on postoperative opioid related-side effects after open HEPatectomy: a multicentre prospective randomized controlled study
Protocol code: 35RC23_8878_ILHEP
Sponsor: Centre Hospitalier Universitaire De Rennes (Hospital/Clinic/Other health care facility). Phase: Therapeutic use (Phase IV). Countries: France (authorised, recruitment pending).
Therapeutic area(s): Analytical, Diagnostic and Therapeutic Techniques and Equipment [E] - Anesthesia and Analgesia [E03]
Gender: Female, Male. Age: 18-64 years, 65+ years. Enrolment: 312.
Status: Authorised, recruitment pending. Decision date: 2026-03-10. Results received: No. Last updated: 2026-03-10.

Condition(s): Postanesthetic complications in patients undergoing open hepatectomy
Product: SODIUM CHLORIDE, LIDOCAINE HYDROCHLORIDE

Primary endpoint: Composite endpoint defined as the occurrence of a postoperative opioid-related adverse event within the first 48 hours after extubation, like : postoperative nausea and vomiting, postoperative hypoxemia (SpO₂ < 95% requiring oxygen supplementation), or postoperative ileus (intolerance to an oral diet, e.g., soft food or light meal), assessed blinded to the randomization group.
Endpoint(s): Occurrence of a postoperative opioid-related nausea and vomiting within the first 48 hours after extubation ; the need for anti-emetic medication will also be recorded, Occurrence of a postoperative opioid-related hypoxemia within the first 48 hours after extubation ; the duration of oxygen treatment will also be recorded, Occurrence of a postoperative opioid-related ileus within the first 48 hours after extubation, Occurrence of a postoperative opioid-related absence of flatus or stools, Postoperative pain (numeric rating scale) after extubation at rest and during movement: every 10 minutes in PACU (Post-Anesthesia Care Unit) and every 6 hours until 48 hours after surgery, Opioid consumption (mg) during the 48 hours following extubation, Time between extubation (H0) and an Aldrete score ≥ 9, Rate of unscheduled admission in intensive care unit, Hospital length of stay (max 28 days) defined as the number of days after extubation (H0) before first hospital discharge, Pneumonia episodes of newly confirmed pneumonia according to the modified CDC criteria within 7 days after surgery or until patient’s discharge from the hospital (max 28 days), Acute kidney insufficiency defined with KDIGO ≥ 2 within 7 days after surgery or until patient’s discharge from the hospital (max 28 days), Need for reintervention because of surgical complication within 7 days after surgery or until patient’s discharge from the hospital (max 28 days), New onset of postoperative atrial fibrillation within 7 days after surgery or until patient’s discharge from the hospital (max 28 days), Quality of recovery measured with the QoR40 score between 24 and 48 hours after extubation, Adverse effects of IV experimental treatment, Ancillary pharmacological study in 20 patients included in the coordinating centre: plasma lidocaine concentration

Source: https://euclinicaltrials.eu/ctis-public/view/2025-522462-73-00